EU clinical trial 2023-507384-20-00: The ENERGY Study: An Open-Label Study to Evaluate the Safety, Tolerability, Pharmacokinetics, and Pharmacodynamics of INZ-701 in Infants with Ectonucleotide Pyrophosphatase/ Phosphodiesterase 1 (ENPP1) Deficiency or ATP-binding Cassette Sub-family C Member 6 (ABCC6) Deficiency
Protocol code: INZ701-104
Sponsor: Inozyme Pharma Inc. (Pharmaceutical company). Phase: Human Pharmacology (Phase I)- Other. Countries: Spain (ended).
Therapeutic area(s): Diseases [C] - Congenital, Hereditary, and Neonatal Diseases and Abnormalities [C16]
Gender: Female, Male. Age: 0-17 years. Enrolment: 2.
Status: Ended. Start date (EU): 2024-10-21. End date (EU): 2025-04-10. Decision date: 2024-03-11. Results received: No. Last updated: 2025-04-10.

Condition(s): Ectonucleotide Pyrophosphatase/Phosphodiesterase 1 (ENPP1) Deficiency or ATP-binding Cassette Sub-family C Member 6 (ABCC6) Deficiency
Product: INZ-701, INZ-701

Primary endpoint: Adverse events (incidence, frequency, and severity of AEs, TEAEs, AESIs, and SAEs), Vital signs and weight, Laboratory tests including chemistry, hematology, and if feasible, urine tests, Immunogenicity, Concomitant medications, Left ventricular ejection fraction via echocardiogram, Electrocardiogram
Endpoint(s): Measurement of INZ-701 serum concentration-time profiles and PK parameters, Change from Baseline over time in PPi levels through Week 52, Measurement of ENPP1 activity, Please refer to the protocol for Exploratory endpoints

Source: https://euclinicaltrials.eu/ctis-public/view/2023-507384-20-00